EU clinical trial 2023-504020-25-00: An Extension Study to Monitor Long-Term Safety of LUM-201 Treatment in Children with Idiopathic Growth Hormone Deficiency
Protocol code: LUM-201-02
Sponsor: Lumos Pharma Inc. (Pharmaceutical company). Phase: Therapeutic exploratory (Phase II). Countries: Poland (ongoing, recruiting).
Therapeutic area(s): Diseases [C] - Hormonal diseases [C19]
Gender: Female, Male. Age: 0-17 years. Enrolment: 21.
Status: Ongoing, recruiting. Start date (EU): 2023-12-28. Decision date: 2023-10-02. Results received: No. Last updated: 2025-08-20.

Condition(s): Idiopathic Growth Hormone Deficiency
Product: LUM-201

Primary endpoint: 1. Occurrence of AEs, SAEs; laboratory results, and physical examination findings.
Endpoint(s): 1. GH values: actual and change over time (every 6 months)., 2. IGF-1 values: actual and change over time (every 6 months)., 3. IGFBP-3 values: actual and change over time (every 6 months)., 4. Change in height standard deviation score (HT-SDS) every 6 months., 5. Change in weight and weight SDS every 6 months., 6. Change in body mass index (BMI) and BMI SDS every 6 months., 7. Change in Bone Age (BA) compared to Chronological Age (CA) (e.g., BA/CA) ratio assessed annually.

Source: https://euclinicaltrials.eu/ctis-public/view/2023-504020-25-00